EU clinical trial 2024-517413-33-00: Safety, Tolerability and Symptomatic Efficacy of the ROCK-Inhibitor Fasudil in Patients with Parkinson's Disease (ROCK-PD)
Protocol code: ROCK-PD-0000-LIN-007
Sponsor: Klinikum der Technischen Universitaet Muenchen (TUM Klinikum) (Hospital/Clinic/Other health care facility). Phase: Therapeutic exploratory (Phase II). Countries: Germany (ongoing, recruitment ended).
Therapeutic area(s): Diseases [C] - Nervous System Diseases [C10]
Gender: Female, Male. Age: 18-64 years, 65+ years. Enrolment: 75.
Status: Ongoing, recruitment ended. Start date (EU): 2026-02-03. Decision date: 2024-09-30. Results received: No. Last updated: 2026-03-18.

Condition(s): Idiopathic Parkinson's Disease
Product: ROCK_PD_low_dose, ROCK_PD_high_dose, Quinina Labesfal 250 mg/ml Solução injetável

Primary endpoint: Combined occurrence of intolerance (termination of treatment because of treatment-related AE) and occurence of self-reported and pre-defined (laboratory, vital signs) treatment-related SAEs [time frame: from day 1 to day 22]
Endpoint(s): Occurrence of intolerance (termination of treatment because of treatment-related AE) [time frame: from day 1 to day 22]., Occurrence of self-reported and pre-defined (laboratory, vital signs) treatment-related SAEs [time frame: from day 1 to day 22, and day 1 to day 50]., the change of MDS-Unified PD Rating Scale (MDS-UPDRS) each part I to IV [time frame: part I and II from day 1 to day 22, and day 1 to day 50; time frame: part III and IV from day 1 to day 10, day 1 to day 22, and day 1 to day 50], the change of MDS-Unified PD Rating Scale (MDS-UPDRS) score part I to IV, the change of 8-item PD Quality of Life Scale (PDQ-8) [time frame: from day 1 to day 22, and day 1 to day 50], the change of PD Non-Motor Symptom Questionnaire (NMSQuest) [time frame: from day 1 to day 10, day 1 to day 22, and day 1 to day 50], the change of Montreal Cognitive Assessment (MoCA) [time frame: from day 1 to day 22, and day 1 to day 50], the change of Becks depression inventory-II (BDI-II) [time frame: from day 1 to day 22, and day 1 to day 50],, the Global Impression of Improvement score (CGI-I [clinician], PGI-I [patient]) [time point: at day 10, 22 and day 50].

Source: https://euclinicaltrials.eu/ctis-public/view/2024-517413-33-00